EU clinical trial 2025-525144-18-00: A PHASE IB/II STUDY TO EVALUATE SAFETY AND EFFICACY OF BEXMARILIMAB IN COMBINATION WITH DOXORUBICIN IN METASTATIC SOFT-TISSUE SARCOMA (BEXAR Study)
Protocol code: MEDOPP0799
Sponsor: Medica Scientia Innovation Research S.L. (Pharmaceutical company). Phase: Phase I and Phase II (Integrated)- Other. Countries: Spain (ongoing, recruiting).
Therapeutic area(s): Diseases [C] - Neoplasms [C04]
Gender: Female, Male. Age: 18-64 years. Enrolment: 278.
Status: Ongoing, recruiting. Start date (EU): 2026-07-31. Decision date: 2026-06-08. Results received: No. Last updated: 2026-07-24.

Condition(s): Advanced or metastatic histologically confirmed soft tissue sarcoma (STS) in adult patients who are not candidates for curative treatment.
Product: Bexmarilimab, DOXORUBICIN

Primary endpoint: Phase Ib – Primary Endpoint The MTD and RP2D of bexmarilimab when used in combination with doxorubicin will be reported based upon evaluation of dose-limiting toxicities (DLTs), adverse events (AEs) and other available data from secondary endpoints., Phase II – Primary Endpoint - PFS, defined as the period from treatment randomization to the first occurrence of disease progression or death from any cause, whichever occurs first, as determined locally by the Investigator using RECIST v1.1.
Endpoint(s): Phase Ib.1. PFS rate at 6 months, defined as the rate of participants with absence of disease progression or death from any cause after the treatment initiation, as determined locally by the investigator using RECIST v.1.1., Phase Ib.2. ORR, defined as the rate of participants with complete response (CR) or partial response (PR), as determined locally by the investigator using RECIST v.1.1, Phase Ib.3. CBR, defined as the rate of participants with an objective response (CR or PR), or stable disease for at least 24 weeks, as determined locally by the investigator using RECIST v.1.1., Phase Ib.4. TTR, defined as the period from treatment randomization to time of the first objective tumor response (tumor shrinkage of ≥ 30%) observed for participants who achieved CR or PR, as determined locally by the investigator using RECIST v.1.1., Phase Ib.5. DoR, defined as the period from the first occurrence of a documented objective response to disease progression or death from any cause, whichever occurs first, as determined locally by the investigator using RECIST v.1.1., Phase Ib.6. iPFS, defined as the period from treatment randomization to the first occurrence of confirmed disease progression (iCPD) or death from any cause, whichever occurs first, as determined locally by the Investigator using iRECIST., Phase Ib.7. iDoR, defined as the period from the first occurrence of a documented objective response to confirmed disease progression (iCPD) or death from any cause, whichever occurs first, as determined locally by the investigator using RECIST v.1.1., Phase II. 1. ORR, defined as the rate of participants with complete response (CR) or partial response (PR), as determined locally by the investigator using RECIST v.1.1., Phase II. 2. CBR, defined as the rate of participants with an objective response (CR or PR), or stable disease for at least 24 weeks, as determined locally by the investigator using RECIST v.1.1., Phase II. 3. TTR, defined as the period from treatment randomization to time of the first objective tumor response (tumor shrinkage of ≥ 30%) observed for participants who achieved CR or PR, as determined locally by the investigator using RECIST v.1.1., Phase II. 4. DoR, defined as the period from the first occurrence of a documented objective response to disease progression or death from any cause, whichever occurs first, as determined locally by the investigator using RECIST v.1.1., Phase II.5. iPFS, defined as the period from treatment randomization to the first occurrence of confirmed disease progression (iCPD) or death from any cause, whichever occurs first, as determined locally by the Investigator using iRECIST., Phase II. 6. iDoR, defined as the period from the first occurrence of a documented objective response to confirmed disease progression (iCPD) or death from any cause, whichever occurs first, as determined locally by the investigator using RECIST v.1.1., Phase II. 7. OS, defined as the period from treatment randomization to death from any cause., Phase II. 8. OS rate, defined as the proportion of alive participants 12 months after randomization.

Source: https://euclinicaltrials.eu/ctis-public/view/2025-525144-18-00